EU clinical trial 2024-515049-41-00: Surgical treatment with or without apalutamide in subjects with high risk prostate cancer who are candidates for radical prostatectomy and staged as oligometastatic with PSMA-PET (STAPLE)
Sponsor: Universita' Degli Studi Di Torino (Educational Institution). Phase: Therapeutic exploratory (Phase II). Countries: Italy (ongoing, recruiting).
Therapeutic area(s): Diseases [C] - Neoplasms [C04]
Gender: Male. Age: 18-64 years, 65+ years. Enrolment: 94.
Status: Ongoing, recruiting. Start date (EU): 2024-07-12. Decision date: 2024-08-13. Results received: No. Last updated: 2026-04-07.

Condition(s): metastatic prostate cancer
Product: Erleada 60 mg film-coated tablets, APALUTAMIDE

Primary endpoint: Radiological progression-free survival (RPFS), evaluated based on PSMA PET/CT
Endpoint(s): Adverse events (AEs), Biochemical progression-free survival (BPFS)* Progression-free survival 2 (PFS2) Time to castration-resistant PCa (CRPC) Percentage of subjects receiving postoperative radiotherapy Overall survival (OS), Change from baseline over time in Expanded Prostate Cancer Index (EPIC-26) and EQ-5D-5L

Source: https://euclinicaltrials.eu/ctis-public/view/2024-515049-41-00